EU clinical trial 2025-521438-27-00: A study to test different doses of BI 3923948 alone and in combination with an anti-PD-1 antibody in people with different types of advanced cancer (solid tumors)
Protocol code: 1538-0001
Sponsor: Boehringer Ingelheim International GmbH, Boehringer Ingelheim Espana S.A. (Pharmaceutical company). Phase: Human Pharmacology (Phase I)- First administration to humans. Countries: Sweden (authorised, recruitment pending), France (authorised, recruitment pending), Spain (authorised, recruitment pending), Germany (authorised, recruitment pending).
Therapeutic area(s): Diseases [C] - Neoplasms [C04]
Gender: Female, Male. Age: 18-64 years, 65+ years. Enrolment: 35.
Status: Authorised, recruitment pending. Decision date: 2026-02-19. Results received: No. Last updated: 2026-07-16.
Decision dates by country: SE: 2026-02-20, FR: 2026-03-06, DE: 2026-02-19, ES: 2026-02-19

Condition(s): advanced, unresectable and/or metastatic solid tumors

Source: https://euclinicaltrials.eu/ctis-public/view/2025-521438-27-00